EU clinical trial 2025-523158-15-00: A multi-center, open-label, drug-drug interaction study to evaluate the effect of pralsetinib (Gavreto) on the pharmacokinetics of CYP3A4, CYP2C8, and CYP2C9 substrates, and hormones estradiol/norethisterone acetate in patients with advanced or metastatic solid tumors.
Protocol code: RGL-RET-001
Sponsor: Rigel Pharmaceuticals Inc. (Pharmaceutical company). Phase: Phase III and phase IV (Integrated). Countries: Spain (ongoing, recruiting).
Therapeutic area(s): Diseases [C] - Neoplasms [C04]
Gender: Female, Male. Age: 18-64 years, 65+ years. Enrolment: 12.
Status: Ongoing, recruiting. Start date (EU): 2026-02-12. Decision date: 2025-11-25. Results received: No. Last updated: 2026-07-17.

Condition(s): Patients with advanced or metastatic solid tumors
Product: GAVRETO ®(pralsetinib) capsules

Primary endpoint: The following PK parameters will be estimated for the probe substrates and their relevant metabolites: • Area under the plasma concentration-time curve from zero to 24 hours (AUC0-inf) • Area under the plasma concentration-time curve from time zero to time of last measurable concentration (AUClast) • Maximum (peak) plasma concentration (Cmax)
Endpoint(s): The following PK parameters will be estimated for the probe substrates and their relevant metabolites: • Time to maximum plasma concentration (tmax) • Terminal half-life (t1/2) • Percent of area under the plasma concentration-time curve obtained at extrapolation (%AUCex) • Mean residence time (MRT) • Terminal elimination rate constant (λz) • Apparent total body clearance (CL/F) • Apparent volume of distribution (Vz/F)

Source: https://euclinicaltrials.eu/ctis-public/view/2025-523158-15-00